EU clinical trial 2024-519852-10-00: Evaluating Bioequivalence of a Fixed Dose Combination versus Tablets of Bempedoic Acid / Ezetimibe and Rosuvastatin.
Protocol code: DSE-BMP-0004-CIS-MA
Sponsor: Daiichi Sankyo Europe GmbH (Pharmaceutical company). Phase: Human Pharmacology (Phase I)- Bioequivalence Study. Countries: Portugal (ended).
Therapeutic area(s): Not possible to specify
Gender: Female, Male. Age: 18-64 years. Enrolment: 58.
Status: Ended. Start date (EU): 2025-09-10. End date (EU): 2025-11-26. Decision date: 2025-08-12. Results received: No. Last updated: 2025-12-16.

Condition(s): No medical condition.

Source: https://euclinicaltrials.eu/ctis-public/view/2024-519852-10-00